EU clinical trial 2023-503594-38-00: Study to Evaluate Adverse Events, Change in Disease Activity, and How Oral ABBV-101 Moves Through the Body in Adult Participants With B-Cell Malignancies
Protocol code: M23-647
Sponsor: Abbvie Deutschland GmbH & Co. KG (Pharmaceutical company). Phase: Human Pharmacology (Phase I)- First administration to humans. Countries: Italy (ongoing, recruitment ended), Spain (ongoing, recruitment ended), France (ongoing, recruitment ended), Germany (ongoing, recruitment ended).
Therapeutic area(s): Diseases [C] - Neoplasms [C04]
Gender: Female, Male. Age: 18-64 years, 65+ years. Enrolment: 225.
Status: Ongoing, recruitment ended. Start date (EU): 2024-07-15. Decision date: 2024-05-22. Results received: No. Last updated: 2026-07-24.
Decision dates by country: FR: 2024-05-27, ES: 2024-05-22, DE: 2024-05-23, IT: 2024-05-22

Condition(s): Select B-Cell malignancies.

Source: https://euclinicaltrials.eu/ctis-public/view/2023-503594-38-00